EU clinical trial 2024-513596-40-00: Intrapleural Fibrinolysis and DNase versus VATS for the treatment of pleural empyema: a randomized, controlled trial
Sponsor: Odense University Hospital (Hospital/Clinic/Other health care facility). Phase: Therapeutic use (Phase IV). Countries: Denmark (ongoing, recruiting).
Therapeutic area(s): Analytical, Diagnostic and Therapeutic Techniques and Equipment [E] - Diagnosis [E01]; Diseases [C] - Bacterial Infections and Mycoses [C01]
Gender: Female, Male. Age: 18-64 years, 65+ years. Enrolment: 184.
Status: Ongoing, recruiting. Start date (EU): 2024-06-28. Decision date: 2024-06-26. Results received: No. Last updated: 2024-06-26.

Condition(s): Pleural empyema
Product: DORNASE ALFA, ALTEPLASE

Endpoint(s): see protocol, see protocol

Source: https://euclinicaltrials.eu/ctis-public/view/2024-513596-40-00